EU clinical trial 2025-524623-50-00: A Phase 1/2 Open-Label, Multicenter Study of RAS(ON) inhibitors in Combination with Ivonescimab with or without Other Anti-Cancer Agents in Patients with Solid Tumors
Protocol code: RMC-APEX-103
Sponsor: Revolution Medicines Inc. (Pharmaceutical company). Phase: Phase I and Phase II (Integrated)- Other. Countries: France (authorised, recruitment pending), Poland (authorised, recruitment pending), Ireland (authorised, recruitment pending), Spain (authorised, recruitment pending), Greece (authorised, recruitment pending), Germany (authorised, recruitment pending), Italy (authorised, recruitment pending), Sweden (authorised, recruitment pending), Belgium (authorised, recruitment pending).
Therapeutic area(s): Diseases [C] - Neoplasms [C04]
Gender: Female, Male. Age: 18-64 years, 65+ years. Enrolment: 252.
Status: Authorised, recruitment pending. Decision date: 2026-06-29. Results received: No. Last updated: 2026-07-23.
Decision dates by country: BE: 2026-06-30, FR: 2026-07-01, DE: 2026-07-01, GR: 2026-06-29, IT: 2026-07-01, ES: 2026-07-03, PL: 2026-07-06, IE: 2026-07-06, SE: 2026-07-22

Condition(s): Solid Tumors
Product: DARAXONRASIB (RMC-6236), RMC-6291, RMC-9805, ivonescimab, Pemetrexed 25 mg/ml concentrate for solution for infusion, Erbitux 5 mg/mL solution for infusion, DARAXONRASIB (RMC-6236), Carboplatin Kabi 10 mg/ml Konzentrat zur Herstellung einer Infusionslösung, RMC-6291, Cisplatin Hikma 1 mg/ml Konzentrat zur Herstellung einer Infusionslösung

Primary endpoint: • Incidence of DLTs (Part 1 and Part 2 safety lead-ins only), • Incidence of AEs, TRAEs, SAEs, and clinically significant changes in laboratory test values and vital signs
Endpoint(s): • RAS(ON) inhibitor concentrations over time as applicable, • ORR and DOR per RECIST v1.1, • DCR, TTR and PFS per RECIST v1.1, • Ivonescimab serum concentrations over time as applicable, • Number and percentage of patients with detectable anti-ivonescimab antibody (ADA) at baseline and post treatment

Source: https://euclinicaltrials.eu/ctis-public/view/2025-524623-50-00